EU clinical trial 2022-500717-64-00: Efficacy of early intravenous high-dose vitamin C in post-cardiac arrest shock: a multicenter, randomized controled to standard treatment, open label trial.
Protocol code: VICEPAC
Sponsor: Centre Hospitalier Bethune Beuvry (Hospital/Clinic/Other health care facility). Phase: Therapeutic exploratory (Phase II). Countries: France (temporarily halted).
Therapeutic area(s): Diseases [C] - Cardiovascular Diseases [C14]
Gender: Female, Male. Age: 18-64 years, 65+ years. Enrolment: 234.
Status: Temporarily halted. Start date (EU): 2023-12-27. Decision date: 2023-03-21. Results received: No. Last updated: 2025-10-03.

Condition(s): cardiac arrest
Product: LAROSCORBINE 1 g/5 ml, solution injectable I.V. en ampoule, ADRENALINE AGUETTANT 1 mg/ml SANS SULFITE, solution injectable, DOBUTAMINE PANPHARMA 250 mg/20 ml, solution à diluer pour perfusion, BEVITINE 100 mg/2 ml, solution injectable en ampoule, NORADRENALINE (TARTRATE) AGUETTANT 2 mg/ml (SANS SULFITES), solution à diluer pour perfusion

Primary endpoint: Cumulative incidence of weaning from vasopressors at day 3 after OHCA.
Endpoint(s): Cumulative incidence of death by refractory shock within 7 days after OHCA., the neurological outcome at day 28 after OHCA, assessed using the mRS (favorable neurological outcome will be considered if mRS range from 0 to 3; Unfavorable neurological outcome will be considered if mRS range from 4 to 6)., The maximal vasopressors infusion dose within 3 days after OHCA., The delta SOFA (sepsis-related organ failure assessment score) is defined as the difference between SOFA admission and SOFA at 72 hours after OHCA. Death within 72 hours will be counted as the maximum SOFA score (i.e. 24 points)., The lower arterial lactate level at day 3 after OHCA.

Source: https://euclinicaltrials.eu/ctis-public/view/2022-500717-64-00